EU clinical trial 2025-521299-76-00: A Modular Phase I/II, Open-label, Multi-Centre Study to Evaluate the Safety, Tolerability, Pharmacokinetics, Pharmacodynamics, and Preliminary Efficacy of AZD3632 Monotherapy or in Combination With Anticancer Agents in Participants with Advanced Haematologic Malignancies with KMT2Ar, NPM1m, or Other Genotypes Associated with HOX Overexpression
Protocol code: D8620C00001
Sponsor: AstraZeneca AB (Pharmaceutical company). Phase: Phase I and Phase II (Integrated)- First administration to humans. Countries: Germany (ongoing, recruiting), Italy (ongoing, recruiting), Denmark (authorised, recruiting).
Therapeutic area(s): Diseases [C] - Neoplasms [C04]
Gender: Female, Male. Age: 18-64 years, 65+ years. Enrolment: 17.
Start date (EU): 2025-12-18. Decision date: 2025-12-08. Results received: No. Last updated: 2025-12-10.
Decision dates by country: DK: 2025-12-08, DE: 2025-12-09, IT: 2025-12-10

Condition(s): Relapsed or refractory acute leukaemia or Myelodysplastic Syndromes with HOX overexpression genotypes
Product: AZD3632, AZD3632

Primary endpoint: Module 1 - Incidence of DLT during the DLT evaluation period, Module 1 - Frequency of dose modifications, delays, and discontinuations due to AEs, Module 1 - Incidence TEAEs, TRAEs and SAEs, Module 1 - Changes from baseline in laboratory evaluations, 12-lead ECGs, performance status, physical examination, and vital signs, Module 2 - Frequency of dose modifications, delays, and discontinuations due to AEs, Module 2 - Incidence of TEAEs, TRAEs, and SAEs, Module 2 - Changes from baseline in laboratory evaluations, 12-lead ECGs, performance status, physical examination, and vital signs
Endpoint(s): Module 1 - Plasma concentrations and PK parameters, including but not limited to Cmax, Tmax, Ctrough, AUCinf, AUC0-t, AUCtau, CL/F, Vz/F, and t1/2 of AZD3632 as permitted by the data (additional PK parameters may be determined where appropriate), Module 1 - Plasma concentrations and PK parameters, including but not limited to Cmax, Cmin, Tmax, AUC0-t, AUCtau under fasted and fed state, Module 1 - Ratio of Cmax, AUC0-t and AUCtau between fed and fasted state, Module 1 - Acute leukaemia: Complete Response (CR) / Complete Response with partial Haematologic recovery (CRh) rate, Module 1 - Acute leukaemia: Time to response (TTR), Module 1 - Acute leukaemia: Duration of response (DoR), Module 1 - Acute leukaemia: Transfusion independence (TI), Module 1 - Acute leukaemia: Event-free survival (EFS), Module 1 - Acute leukaemia: Overall survival (OS), Module 1 - Acute leukaemia: Percentage of participants who receive subsequent allogeneic hematopoietic stem cell transplant (HSCT), Module 1 - Myelodysplastic Syndromes: Overall Response Rate (ORR): CR (or CR equivalent), Partial Response (PR), CRL, CRh, or haematologic improvement (HI), Module 1 - Myelodysplastic Syndromes: TTR, DoR, TI, Time to Progression to AML, EFS, OS, Percentage of participants who receive subsequent HSCT, Module 2 - Plasma PK parameters including but not limited to (AUC0-t, Cmax, and Tmax) of AZD3632 after administration of AZD3632 alone and in combination with posaconazole, Module 2 - Plasma GMR (Cmax and AUC) of AZD3632 evaluated with and without posaconazole, Module 2 - Plasma PK of posaconazole, Module 2 - Acute leukaemia: CR/CRh, TTR, DoR, TI, EFS, OS, percentage of participants who receive subsequent HSCT, Module 2 - Myelodysplastic Syndromes: ORR, TTR, DoR, TI, Time to progression to AML, EFS, OS, percentage of participants who receive subsequent HSCT

Source: https://euclinicaltrials.eu/ctis-public/view/2025-521299-76-00